EU clinical trial 2024-514877-23-00: VENTOGRAFT study: A phase I-II study to assess venetoclax + azacitidine and donor lymphocyte infusion in patients with MDS or AML in relapse after allo hematopoietic stem cell transplantation
Protocol code: VENTOGRAFT
Sponsor: Groupe Francophone Des Myelodysplasies (Patient organisation/association). Phase: Phase I and Phase II (Integrated)- Other. Countries: France (ongoing, recruitment ended).
Therapeutic area(s): Diseases [C] - Hemic and Lymphatic Diseases [C15]
Gender: Female, Male. Age: 18-64 years, 65+ years. Enrolment: 55.
Status: Ongoing, recruitment ended. Start date (EU): 2022-11-23. Decision date: 2024-10-07. Results received: No. Last updated: 2026-06-29.

Condition(s): Myelodysplastic syndromes or Acute Myeloid Leukemia
Product: Venetoclax, Venetoclax, Venetoclax, Vidaza 25 mg/ml powder for suspension for injection

Primary endpoint: Phase I: To determine toxicity profile and safety of the combination, Phase II: Overall hematological response rate of venetoclax in combination with AZA/DLI. Response assessment will be performed for MDS according to IWG criteria and according to European LeukemiaNet criteria for AML.
Endpoint(s): Toxicity as measured by NCI CTCAE 5.0, Acute and chronic GVHD rate, Duration of response, Overall survival, Progression-free survival, Event-free survival

Source: https://euclinicaltrials.eu/ctis-public/view/2024-514877-23-00